EU clinical trial 2023-506880-32-01: A study for GSK3862995B in healthy participants and participants with Chronic Obstructive Pulmonary Disease
Protocol code: 221531
Sponsor: Glaxosmithkline Research & Development Limited (Pharmaceutical company). Phase: Human Pharmacology (Phase I)- First administration to humans. Countries: Germany (ongoing, recruitment ended).
Therapeutic area(s): Diseases [C] - Respiratory Tract Diseases [C08]
Gender: Female, Male. Age: 18-64 years, 65+ years. Enrolment: 55.
Status: Ongoing, recruitment ended. Start date (EU): 2025-04-14. Decision date: 2025-01-22. Results received: No. Last updated: 2026-05-26.

Condition(s): Pulmonary Disease, Chronic Obstructive

Source: https://euclinicaltrials.eu/ctis-public/view/2023-506880-32-01